EU clinical trial 2023-508449-41-00: A Phase 3 Study of Pembrolizumab in Combination with Carboplatin/Taxane (Paclitaxel or Nab-paclitaxel) Followed by Pembrolizumab with or without Maintenance Olaparib in the First-line Treatment of Metastatic Squamous Non-small Cell Lung Cancer (NSCLC)
Protocol code: MK-7339-008
Sponsor: Merck Sharp & Dohme LLC (Pharmaceutical company). Phase: Therapeutic confirmatory (Phase III). Countries: Germany (ended), Austria (ended), Spain (ended), France (ended), Poland (ended), Romania (ended).
Therapeutic area(s): Diseases [C] - Neoplasms [C04]
Gender: Female, Male. Age: 18-64 years, 65+ years. Enrolment: 151.
Status: Ended. Start date (EU): 2019-06-26. End date (EU): 2026-01-30. End date: 2026-01-31. Decision date: 2024-03-22. Results received: No. Last updated: 2026-01-19.
Decision dates by country: DE: 2024-03-25, FR: 2024-04-17, PL: 2024-03-28, RO: 2024-03-27, AT: 2024-03-22, ES: 2024-03-22

Condition(s): Metastatic Squamous Non-small Cell Lung Cancer (NSCLC)
Product: PACLITAXEL, CARBOPLATIN, KEYTRUDA 25 mg/mL concentrate for solution for infusion, Olaparib, Placebo to MK-7339 100 mg, Placebo to MK-7339 150 mg, Olaparib, PACLITAXEL ALBUMIN-BOUND

Primary endpoint: Progression-free Survival (PFS) Per Response Evaluation Criteria in Solid Tumors Version 1.1 (RECIST 1.1), Overall Survival (OS)
Endpoint(s): Number of Participants With One or More Adverse Events (AEs), Number of participants discontinuing study intervention due to adverse events (AEs), Change from Baseline in European Organization for Research and Treatment of Cancer (EORTC) Quality of Life Questionnaire-Core 30 (QLQ-C30) Global Health Status / Quality of Life (Items 29 and 30) Scale Score, Change from Baseline in European Organization for Research and Treatment of Cancer (EORTC) Quality of Life Questionnaire Lung Cancer Module 13 (QLQ-LC13) Cough (Item 1) Scale Score, Change from Baseline in European Organization for Research and Treatment of Cancer (EORTC) Quality of Life Questionnaire Lung Cancer Module 13 (QLQ-LC13) Chest Pain (Item 10) Scale Score, Change from Baseline in European Organization for Research and Treatment of Cancer (EORTC) Quality of Life Questionnaire-Core 30 (QLQ-C30) Dyspnea (Item 8) Scale Score, Change from Baseline in European Organization for Research and Treatment of Cancer (EORTC) Quality of Life Questionnaire-Core 30 (QLQ-C30) Physical Functioning (Items 1 to 5) Scale Score, Time to True Deterioration (TTD) in European Organization for Research and Treatment of Cancer (EORTC) Quality of Life Questionnaire-Core 30 (QLQ-C30) Global Health Status / Quality of Life (Items 29 and 30) Scale Score, Time to True Deterioration (TTD) in European Organization for Research and Treatment of Cancer (EORTC) Quality of Life Questionnaire Lung Cancer Module 13 (QLQ-LC13) Cough (Item 1) Scale Score, Time to True Deterioration (TTD) in European Organization for Research and Treatment of Cancer (EORTC) Quality of Life Questionnaire Lung Cancer Module 13 (QLQ-LC13) Chest Pain (Item 10) Scale Score, Time to True Deterioration (TTD) in European Organization for Research and Treatment of Cancer (EORTC) Quality of Life Questionnaire-Core 30 (QLQ-C30) Dyspnea (Item 8) Scale Score, Time to True Deterioration (TTD) in European Organization for Research and Treatment of Cancer (EORTC) Quality of Life Questionnaire-Core 30 (QLQ-C30) Physical Functioning (Items 1 to 5) Scale Score

Source: https://euclinicaltrials.eu/ctis-public/view/2023-508449-41-00